EU clinical trial 2025-523586-18-00: ROSETTA Lung-202: A Randomized, Double-Blind, Phase 3 Study of Pumitamig Monotherapy Compared to Pembrolizumab as First-line Treatment in Participants with Locally Advanced or Metastatic Non-Small Cell Lung Cancer with PD-L1 ≥ 50%
Protocol code: CA2660002
Sponsor: Bristol-Myers Squibb Services Unlimited Company (Pharmaceutical company). Phase: Therapeutic confirmatory (Phase III). Countries: Portugal (authorised, recruiting), Norway (authorised, recruitment pending), Sweden (not authorised), Bulgaria (authorised, recruitment pending), France (ongoing, recruiting), Belgium (authorised, recruitment pending), Austria (authorised, recruiting), Germany (ongoing, recruiting), Finland (authorised, recruitment pending), Poland (authorised, recruitment pending), Romania (authorised, recruitment pending), Netherlands (authorised, recruiting), Spain (ongoing, recruiting), Italy (ongoing, recruiting), Hungary (authorised, recruitment pending), Czechia (authorised, recruiting).
Therapeutic area(s): Diseases [C] - Neoplasms [C04]
Gender: Female, Male. Age: 18-64 years, 65+ years. Enrolment: 265.
Start date (EU): 2026-06-11. Decision date: 2026-05-15. Results received: No. Last updated: 2026-06-26.
Decision dates by country: AT: 2026-05-17, BE: 2026-05-18, BG: 2026-05-26, CZ: 2026-05-19, FR: 2026-05-20, HU: 2026-05-20, IT: 2026-05-19, PT: 2026-05-15, ES: 2026-05-19, SE: 2026-05-20, NO: 2026-05-19, PL: 2026-05-19, RO: 2026-05-27, FI: 2026-06-01, NL: 2026-06-03, DE: 2026-05-19

Condition(s): Non-Small Cell Lung Cancer
Product: BNT327 50 mg ml, BNT327 20 mg ml, PEMBROLIZUMAB

Primary endpoint: Progression-free survival (PFS) assessed by BICR, to see if pumitamig works better than pembrolizumab by evaluating how long it takes before the cancer starts growing again by radiographic imaging techniques, Overall Survival (OS), to assess if people live longer when they take pumitamig compared to pembrolizumab
Endpoint(s): overall response of pumitamig versus pembrolizumab, how safe each medicine is, how well participants tolerate the medicines

Source: https://euclinicaltrials.eu/ctis-public/view/2025-523586-18-00